EU clinical trial 2024-520159-26-00: Exploratory Phase 2 Randomized, Double-blind, Placebo-Controlled Study to Evaluate the Safety and Impact on HIV-1 Reservoir of Baricitinib in Virologically Suppressed People With HIV-1
Protocol code: BCN05-Bari
Sponsor: Fundacion Fls De Lucha Contra El Sida Las Enfermedades Infecciosas Y La Promocion De La Salud Y La Ciencia (Patient organisation/association). Phase: Therapeutic exploratory (Phase II). Countries: Spain (ongoing, recruitment ended).
Therapeutic area(s): Diseases [C] - Virus Diseases [C02]
Gender: Female, Male. Age: 18-64 years. Enrolment: 30.
Status: Ongoing, recruitment ended. Start date (EU): 2025-09-17. Decision date: 2025-05-09. Results received: No. Last updated: 2025-05-09.

Condition(s): Human immunodeficency virus
Product: Olumiant 2 mg film-coated tablets, Maltodextrine powder

Primary endpoint: Proportion of participants developing Grade 3 or 4 treatment-related adverse events or laboratory abnormalities during the study, based on the Division of AIDS (DAIDS) Table for grading the Severity of Adult and Pediatric Adverse Events, Corrected Version 2.1 [July 2017]. Safety laboratory tests will be performed at weeks 0, 4, 12 and 24., Levels of pSTAT 1, 3 and 5 in CD4+ T cells, at weeks 0 and 12 measured by Flow cytometry.
Endpoint(s): Changes in levels of BCL-2 in CD4+ T cells, at weeks 0 and 12 measured by Flow cytometry., Changes in levels of IFITM2, pJAK1/2, cleaved-caspase 3 and other pro- apoptotic markers in CD4+ T cells, at weeks 0 and 12 measured by Western blot., Changes in total and intact proviral HIV-1 DNA (IPDA) in CD4 T cells at weeks 0 and 12., Changes in soluble plasma levels of proinflammatory biomarkers (such as IL-2, IL-6, IL-7, IL-15, IL-8, TNFa, IFNg and sCD14) and anti-inflammatory biomarkers (such as IL-10, IL-4, IL-13), at weeks 0 and 12., Changes in T cell immune subsets and frequencies of T cells expressing activation, exhaustion and senescence markers at weeks 0 and 12 measured by multiparametric flow cytometry., Baricitinib concentrations in plasma at weeks 4 and 12.

Source: https://euclinicaltrials.eu/ctis-public/view/2024-520159-26-00